EU clinical trial 2024-511688-27-00: An Open-Label Clinical Trial of RVU120 as Monotherapy and in Combination with Ruxolitinib in Patients with Intermediate or High-Risk, Primary or Secondary Myelofibrosis (POTAMI-61)
Protocol code: POTAMI-61
Sponsor: Ryvu Therapeutics S.A. (Pharmaceutical company). Phase: Therapeutic exploratory (Phase II). Countries: Poland (ended), Italy (ended).
Therapeutic area(s): Diseases [C] - Neoplasms [C04]
Gender: Female, Male. Age: 18-64 years, 65+ years. Enrolment: 83.
Status: Ended. Start date (EU): 2024-09-19. End date (EU): 2026-06-30. Decision date: 2024-08-28. Results received: No. Last updated: 2025-12-16.
Decision dates by country: IT: 2024-08-28, PL: 2024-08-30

Condition(s): Myelofibrosis
Product: Jakavi 15 mg tablets, Jakavi 20 mg tablets, Jakavi 5 mg tablets, Jakavi 20 mg tablets, Jakavi 5 mg tablets, SEL120 monohydrochloride, Jakavi 5 mg tablets, Jakavi 15 mg tablets, Jakavi 20 mg tablets, SEL120 monohydrochloride, Jakavi 15 mg tablets, Jakavi 10 mg tablets, Jakavi 10 mg tablets, Jakavi 10 mg tablets

Primary endpoint: The proportion of participants achieving Spleen Volume Reduction (SVR) of ≥35% after 24 weeks of commencing study treatment by magnetic resonance imaging (MRI) or computed tomography (CT) scan
Endpoint(s): The proportion of participants achieving ≥1 Grade bone marrow fibrosis improvement after 24 weeks of commencing study treatment, Duration of Spleen Response assessed as time from initial SVR of ≥35% by MRI/CT until disease progression or death, whichever occurs first, Leukemic transformation as evidenced by bone marrow blast counts of at least 20%, or peripheral blast counts of at least 20% lasting 2 weeks, Hematologic (clinical) improvement as defined by International Working Group (IWG) Consensus Criteria 2006, Progression-Free Survival, Overall Survival, Incidence and severity of adverse events (AEs), PK of RVU120 including Cmax, tmax, AUCtau, and AUCinf, and t½, The proportion of participants achieving at least a 50% reduction in Total Symptom Score (TSS) after 24 weeks of commencing study treatment, For all participants, assessment of the absolute change in TSS from baseline

Source: https://euclinicaltrials.eu/ctis-public/view/2024-511688-27-00